EU clinical trial 2023-505556-21-00: Efficacy and safety of 24 weeks sustained-release dexamphetamine in patients with moderate to severe cocaine use disorder with comorbid opioid use disorder - a multicenter randomized, double-blind, placebo-controlled study
Protocol code: 10140262110025
Sponsor: Parnassia Groep B.V. (Hospital/Clinic/Other health care facility). Phase: Therapeutic confirmatory (Phase III). Countries: Netherlands (ongoing, recruiting).
Therapeutic area(s): Psychiatry and Psychology [F] - Mental Disorders [F03]
Gender: Female, Male. Age: 18-64 years, 65+ years. Enrolment: 204.
Status: Ongoing, recruiting. Start date (EU): 2026-03-12. Decision date: 2024-11-04. Results received: No. Last updated: 2026-03-08.

Condition(s): cocaine use disorder
Product: Placebo tablets (containing a subtherapeutic dose of 1.25 mg piracetam as adherence marker; see attached IMPD), Dexamphetamine sulfate/piracetam sustained release tablets (30.0/1.25 mg)

Primary endpoint: The primary endpoint is defined as the number of days of cocaine abstinence in the final 4 weeks of treatment (i.e., weeks 21–24), assessed by combined self-report and urinalysis., The key secondary endpoint is defined as "good or improved overall health status", in terms of physical health, mental health, and social functioning
Endpoint(s): The number and proportion of patients starting and completing 24 weeks treatment, Maximum dose received; dose at the end of week 4; dose in final 4 weeks of study phase 1 (weeks 21–24); dose in final 4 weeks of study phase 2 (weeks 27–30), Safety will be assessed and reported in terms of: Vital signs (heart rate, blood pressure) and body weight; ECG and safety laboratory parameters (NT-proBNP, and hs-Troponine); Adverse events (AEs; solicited and unsolicited) and serious adverse events (SAEs), The number of days cocaine abstinence in the final 4 weeks of the discontinuation phase of the study (i.e., weeks 27–30), The overall health status of patients in the final 4 weeks of the discontinuation study phase 2 (weeks 27–30), - defined as "deteriorated overall health status", in terms of physical health, mental health, and social functioning -, A dichotomous outcome of deterioration (yes versus no) based on the composite outcome of (1) a clinically relevant decrease of ≥5 days/month in cocaine abstinent days and/or (2) deterioration in overall health status., Total number of days cocaine abstinence during first 12 weeks treatment (i.e., 0–84 days), Total number of days cocaine abstinence during 24 weeks treatment (i.e., 0–168 days)., Complete abstinence from cocaine during 24 weeks treatment., Achieving a period of sustained abstinence from cocaine for at least 21 consecutive days., At least 40% reduction in cocaine use (days/month) in the final 4 weeks of treatment (weeks 21–24), compared with baseline., Number of weeks of uninterrupted cocaine abstinence sustained till abstinence during final treatment week in study phase 1, Average number of cocaine administrations on days that cocaine was used., Cocaine craving

Source: https://euclinicaltrials.eu/ctis-public/view/2023-505556-21-00